EU clinical trial 2024-511679-14-00: Improving outcome in subarachnoid hemorrhage with nadroparin
Sponsor: Amsterdam UMC Stichting (Hospital/Clinic/Other health care facility). Phase: Therapeutic exploratory (Phase II). Countries: Netherlands (ongoing, recruiting).
Therapeutic area(s): Diseases [C] - Cardiovascular Diseases [C14]; Diseases [C] - Nervous System Diseases [C10]
Gender: Female, Male. Age: 18-64 years, 65+ years. Enrolment: 100.
Status: Ongoing, recruiting. Start date (EU): 2024-08-08. Decision date: 2024-08-08. Results received: No. Last updated: 2024-08-08.

Condition(s): subarachnoid hemorrhage
Product: NADROPARINE CALCIQUE ASPEN 5 700 UI / 0,6 mL, solution injectable en seringue préremplie, NADROPARINE CALCIQUE ASPEN 2 850 UI / 0,3 mL, solution injectable en seringue préremplie

Primary endpoint: 30-days’ mortality
Endpoint(s): Delayed cerebral ischemia, Venous thrombo-embolic complications, Intra- and extracranial hemorrhagic complications, Hemorrhage after external CSF drainage, Rate of other SAH-related complications with subdividing into types of complications, Hydrocephalus, Discharge location, Quality of life, Cognitive functioning, Clinical outcome (modified Rankin Score), Rate of (micro)infarctions number and volume at MR imaging at six months, Mortality at six months

Source: https://euclinicaltrials.eu/ctis-public/view/2024-511679-14-00